EU clinical trial 2025-524944-37-00: A Pragmatic Randomized Trial to Evaluate the Effect of Recombinant Herpes Zoster Vaccine on Major Adverse Cardiovascular Events and Dementia in Adults Aged 65 Years or Above
Protocol code: DAN-ZOSTER
Sponsor: Gentofte Hospital, GlaxoSmithKline Biologicals (Hospital/Clinic/Other health care facility, Pharmaceutical company). Phase: Therapeutic use (Phase IV). Countries: Denmark (ongoing, recruiting).
Therapeutic area(s): Diseases [C] - Skin and Connective Tissue Diseases [C17]
Gender: Female, Male. Age: 65+ years. Enrolment: 162000.
Status: Ongoing, recruiting. Start date (EU): 2026-04-28. Decision date: 2026-03-04. Results received: No. Last updated: 2026-03-04.

Condition(s): Herpes Zoster
Product: Shingrix powder and suspension for suspension for injection Herpes zoster vaccine (recombinant, adjuvanted), Shingrix powder and suspension for suspension for injection Herpes zoster vaccine (recombinant, adjuvanted)

Primary endpoint: In line with the study’s primary objective of evaluating the effect of Shingrix® on the risk of MACE and new dementia in adults aged 65 years and older, this trial includes the following dual primary time-to-event endpoints: 1) Hospitalization for MACE 2) new dementia
Endpoint(s): The secondary endpoints of this trial are subdivided according to the dual primary endpoints of MACE and new dementia., MACE-related secondary endpoints The MACE related secondary endpoints are as follows: -Composite of hospitalization for non-fatal acute coronary syndrome, non-fatal stroke, or cardiovascular death -Hospitalization for any cardiovascular disease -Hospitalization for stroke -Hospitalization for myocardial infarction -Cardiovascular death Dementia-related secondary endpoints The new dementia related endpoints are as follows: – Alzheimer’s dementia – Vascular dementia – Unspecified dementia

Source: https://euclinicaltrials.eu/ctis-public/view/2025-524944-37-00